EU clinical trial 2022-500438-27-01: Multimodal METformin and FINGER lifestyle intervention to prevent cognitive impairment and disability in older adults at risk for dementia: a phase IIb multi-national randomised, controlled trial.
Protocol code: 21CX6667
Sponsor: Imperial College London (Educational Institution). Phase: Therapeutic exploratory (Phase II). Countries: Sweden (ongoing, recruitment ended), Finland (ongoing, recruitment ended).
Therapeutic area(s): Diseases [C] - Nervous System Diseases [C10]
Gender: Female, Male. Age: 18-64 years, 65+ years. Enrolment: 300.
Status: Ongoing, recruitment ended. Start date (EU): 2023-06-27. Decision date: 2022-07-28. Results received: No. Last updated: 2026-03-24.
Decision dates by country: SE: 2022-07-29, FI: 2022-07-28

Condition(s): Older adults with risk factors for dementia but dementia free and without substantial cognitive impairment. The intervention is aimed at preventing cognitive decline/dementia.
Product: The placebo will be manufactured based on the Glucophage® XR 500 specifications to be identical to the IMP in all respects, except that for the lack of active substance., METFORMIN HYDROCHLORIDE

Primary endpoint: Composite z- score of an extended Neuropsychological Test Battery (NTB) adapted from the FINGER trial
Endpoint(s): Composite z-scores for NTB memory, executive function, and processing speed domains (based on FINGER), Clinical Dementia Rating Sum of Boxes, Instrumental Activities of Daily Living, Healthy Lifestyle Index, a composite score based on exercise, diet, lifestyle cardiovascular risk factors, and social and cognitive activity, BMI, waist, waist/hip ratio, blood pressure, lipid profile and glucose metabolism, Incident cardiovascular disease (e.g., myocardial infarction, angina pectoris, transient ischaemic attack, stroke, peripheral artery disease), FINGER healthy diet index, nutrients and food intake, Self-reported and objectively measured levels of physical activity, Short Physical Performance Battery, hand grip strength, and timed 10-meter dual-task test, Center for Epidemiological Studies-Depression Scale, Perceived Stress Scale, Insomnia Severity Index, RAND36 and 15D scales for health-related quality of life, Self-reported and register data for utilisation of healthcare resources

Source: https://euclinicaltrials.eu/ctis-public/view/2022-500438-27-01